EU clinical trial 2023-510486-10-00: Immunosuppressive Drugs and Gut Microbiome: Pharmacokinetic- and Microbiome Diversity Effects
Sponsor: Oslo University Hospital HF (Hospital/Clinic/Other health care facility). Phase: Therapeutic use (Phase IV). Countries: Norway (ongoing, recruiting).
Therapeutic area(s): Phenomena and Processes [G] - Microbiological Phenomena [G06]
Gender: Female, Male. Age: 18-64 years, 65+ years. Enrolment: 100.
Status: Ongoing, recruiting. Start date (EU): 2024-05-22. Decision date: 2024-05-22. Results received: No. Last updated: 2024-05-22.

Condition(s): Kidney transplantation
Product: CellCept 500 mg film-coated tablets, PROGRAF 1 mg capsule

Primary endpoint: Association between microbiome diversity measures and AUC0-tau and Cmax of mycophenolate and metabolites.
Endpoint(s): Association between microbiome diversity measures and absolute F, AUC0-tau and Cmax of tacrolimus and metabolites., Changes in microbiome diversity measures and mycophenolate (and metabolite) AUC0-tau, Cmax, Tmax and kel with one week of mycophenolate mofetil treatment., Changes in microbiome diversity measures and tacrolimus (and metabolite) AUC0-tau, Cmax, Tmax and kel with one week of tacrolimus treatment, To investigate the indirect association between microbiome diversity and immunosuppressant molecular pharmacodynamics (PD biomarkers)., Descriptive comparison of microbiome diversity measures between the two populations., Associations between TTV viral load and immunosuppressive drug systemic exposure, acute rejection episodes, protocol biopsy scores and other opportunistic infections, e.g. CMV and BK DNAemia and incidence of bacterial infections., Investigate whether immunosuppressant molecular pharmacodynamics (cytokine responses, intracellular drug and drug target levels and down-stream mediators) can be predictive for rejection and adverse effects., Relative predictive error (PE%) and root mean squared error (RMSE%) of the developed pharmacokinetic model., Relative predictive error (PE%) and root mean squared error (RMSE%) of the developed PKPD model

Source: https://euclinicaltrials.eu/ctis-public/view/2023-510486-10-00